EU clinical trial 2023-507019-36-00: A Study to Evaluate Safety, Pharmacokinetics, and Activity of Cevostamab as Monotherapy and Cevostamab Plus Pomalidomide and Dexamethasone or Cevostamab Plus Daratumumab and Dexamethasone in Patients with Relapsed or Refractory Multiple Myeloma (CAMMA 1)
Protocol code: GO42552
Sponsor: Genentech Inc. (Pharmaceutical company). Phase: Human Pharmacology (Phase I)- Other. Countries: France (ongoing, recruitment ended), Czechia (ongoing, recruitment ended), Italy (ongoing, recruitment ended), Spain (ongoing, recruitment ended), Denmark (ongoing, recruitment ended), Poland (ongoing, recruitment ended).
Therapeutic area(s): Diseases [C] - Neoplasms [C04]
Gender: Female, Male. Age: 18-64 years, 65+ years. Enrolment: 50.
Status: Ongoing, recruitment ended. Start date (EU): 2022-07-08. Decision date: 2024-08-27. Results received: No. Last updated: 2026-08-07.
Decision dates by country: FR: 2024-08-29, PL: 2024-09-22, CZ: 2024-08-30, ES: 2024-08-27, DK: 2024-08-28, IT: 2024-09-10

Condition(s): Relapsed or Refractory Multiple Myeloma (R/R MM)

Source: https://euclinicaltrials.eu/ctis-public/view/2023-507019-36-00